EU clinical trial 2022-502840-11-00: A PHASE IB/II, OPEN-LABEL, MULTICENTER, RANDOMIZED PLATFORM STUDY EVALUATING THE EFFICACY AND SAFETY OF NEOADJUVANT IMMUNOTHERAPY COMBINATIONS IN PATIENTS WITH SURGICALLY RESECTABLE HEPATOCEULLULAR CARCINOMA (MORPHEUS-NEO HCC)
Protocol code: GO44457
Sponsor: F. Hoffmann-La Roche AG (Pharmaceutical company). Phase: Phase I and Phase II (Integrated)- Other. Countries: Austria (ended), Spain (ended), Germany (ended), France (ended).
Therapeutic area(s): Diseases [C] - Neoplasms [C04]
Gender: Female, Male. Age: 18-64 years, 65+ years. Enrolment: 55.
Status: Ended. Start date (EU): 2023-11-28. End date (EU): 2025-10-23. End date: 2025-11-13. Decision date: 2023-10-25. Results received: Yes. Last updated: 2025-12-08.
Decision dates by country: AT: 2023-10-30, ES: 2023-10-25, DE: 2023-10-27, FR: 2023-10-30

Condition(s): Hepatocellular Carcinoma (Morpheus-Neo HCC)
Product: Tecentriq 1,200 mg concentrate for solution for infusion, Avastin 25 mg/ml concentrate for solution for infusion., Tiragolumab, RO7247669

Primary endpoint: MPR rate
Endpoint(s): pCR rate, RFS, EFS, OS, ORR, Proportion of participants downstaged to within Milan criteria (for participants beyond criteria at randomization), R0 resection rate (proportion of resected participants obtaining an R0 resection), Incidence, nature, and severity of adverse events, serious adverse events, and immune-related adverse events [severity determined according to National Cancer Institute Common Terminology Criteria for Adverse Events, Version 5.0 (NCI CTCAE v5.0); severity of cytokine release syndrome (CRS) determined according to the American Society for Transplantation and Cellular Therapy (ASTCT) CRS Consensus Grading Scale], Proportion of participants with delayed or canceled surgery due to treatment-related adverse events, as well as length of surgical delay, duration of surgery, length of hospital stay, surgical approach, extent of surgery, intraoperative blood loss, and need for intraoperative blood transfusion, Post-operative surgical complication rates according to the Clavien- Dindo surgical classification, Post-operative mortality

Source: https://euclinicaltrials.eu/ctis-public/view/2022-502840-11-00